EU clinical trial 2025-520741-68-00: Genitourinary Syndrome and Female Sexual Dysfunction: Effect of topical glyceryl trinitrate on female genital function in the peri- and postmenopause – a Pilot Study
Protocol code: NitroVAG
Sponsor: Medical University Of Vienna (Educational Institution). Phase: Human Pharmacology (Phase I)- Other. Countries: Austria (authorised, recruitment pending).
Therapeutic area(s): Diseases [C] - Female Urogenital Diseases and Pregnancy Complications [C13]
Gender: Female. Age: 18-64 years, 65+ years. Enrolment: 32.
Status: Authorised, recruitment pending. Decision date: 2025-02-05. Results received: No. Last updated: 2025-06-02.

Condition(s): Genitourinary Syndrome of Menopause

Source: https://euclinicaltrials.eu/ctis-public/view/2025-520741-68-00